EU clinical trial 2024-517244-57-00: A Phase 1/2, Multicenter, Single Ascending Dose Study to Evaluate the Safety, Tolerability, and Exploratory Efficacy of Intrathecally Administered Gene Therapy AMT-162 in Adult Participants with SOD1 Amyotrophic Lateral Sclerosis (SOD1-ALS)
Protocol code: AMT-162-001
Sponsor: uniQure biopharma B.V. (Pharmaceutical company). Phase: Phase I and Phase II (Integrated)- Other. Countries: Sweden (ongoing, recruitment ended).
Therapeutic area(s): Diseases [C] - Nervous System Diseases [C10]
Gender: Female, Male. Age: 18-64 years, 65+ years. Enrolment: 5.
Status: Ongoing, recruitment ended. Start date (EU): 2025-03-03. Decision date: 2025-01-28. Results received: No. Last updated: 2025-10-23.

Condition(s): Amyotrophic Lateral Sclerosis (ALS)

Primary endpoint: Incidence of treatment-emergent adverse events (TEAEs), Mean change from baseline (BL) in clinical safety laboratory tests, Mean change from BL in vital sign parameters, Mean change from BL in electrocardiogram (ECG) parameters
Endpoint(s): AMT-162 vector shedding, B-cell and T-cell immunological response (neutralizing antibodies to AAVrh10 viral capsid, anti-AAV total IgG/IgM antibodies, and T cell response), Change from BL in slow vital capacity (SVC) percent of predicted value, Hand-held dynamometry (HHD) scores, Neurofilament light chain (NfL) protein levels in serum up to 5 years post-treatment

Source: https://euclinicaltrials.eu/ctis-public/view/2024-517244-57-00